EU clinical trial 2023-507879-21-00: Randomized Evaluation of Treosulfan versus Melphalan conditioning fol-lowed by PTCY in Patients with AML and MDS undergoing allogeneic Transplantation (RELEVANT)
Protocol code: TUD-ETAL-5-084
Sponsor: Technische Universitat Dresden (Educational Institution). Phase: Therapeutic exploratory (Phase II). Countries: Germany (ongoing, recruiting).
Therapeutic area(s): Diseases [C] - Neoplasms [C04]
Gender: Female, Male. Age: 18-64 years, 65+ years. Enrolment: 220.
Status: Ongoing, recruiting. Start date (EU): 2026-01-19. Decision date: 2025-03-05. Results received: No. Last updated: 2026-02-24.

Condition(s): AML and MDS undergoing allogeneic Transplantation
Product: MELPHALAN, FLUDARABINE, TREOSULFAN

Primary endpoint: Overall survival (OS) as time-to-event endpoint
Endpoint(s): - non-relapse mortality (NRM), - Graft-versus-host-free and relapse-free survival (GRFS), - Cumulative incidences of acute and chronic GvHD (NIH criteria), - Rates of AEs/SAEs/AESI, - Cumulative incidence of relapse (CIR) and Relapse-free survival (RFS), - Rate of morphologic and molecular CR/CRh/CRi/MLFS, - Rate of engraftment on day +28 and Rate of complete donor-type chimerism on day +28 and day +56

Source: https://euclinicaltrials.eu/ctis-public/view/2023-507879-21-00